EU clinical trial 2024-513168-24-00: A randomised, controlled, parallel group, open-label trial evaluating the impact of treatment with the GLP-1 analogue semaglutide on weight loss in people living with HIV and obesity (SWIFT Study)
Protocol code: Semaglutide_2019
Sponsor: University College Dublin (Educational Institution). Phase: Therapeutic exploratory (Phase II). Countries: Ireland (ongoing, recruiting), Denmark (ongoing, recruiting), Italy (authorised, recruitment pending).
Therapeutic area(s): Phenomena and Processes [G] - Metabolism [G03]; Diseases [C] - Virus Diseases [C02]
Gender: Female, Male. Age: 18-64 years, 65+ years. Enrolment: 80.
Start date (EU): 2022-06-01. Decision date: 2024-04-29. Results received: No. Last updated: 2026-06-17.
Decision dates by country: DK: 2025-06-30, IT: 2025-07-14, IE: 2024-04-29

Condition(s): HIV & Obesity
Product: Wegovy 0.5 mg FlexTouch solution for injection in pre-filled pen, Wegovy 1 mg FlexTouch solution for injection in pre-filled pen, Wegovy 0.25 mg FlexTouch solution for injection in pre-filled pen, Ozempic 0.5 mg solution for injection in pre-filled pen, Ozempic 1 mg solution for injection in pre-filled pen, Ozempic 0.25 mg solution for injection in pre-filled pen

Primary endpoint: Change from baseline in total body weight at week 28.
Endpoint(s): Change from baseline in total and subcutaneous fat, as measured by DXA at week 28., Changes from baseline to week 28 in markers of B-cell function, T-cell function, innate immunity, inflammation, gut microbiome composition, adipose tissue function, cholesterol and glucose metabolism and HIV RNA and HIV viral reservoir., The proportion of subjects in both arms not achieving ≥ 5% weight loss from baseline at week 16., Proportion with reported AE/AR, SAE/SAR, Change in health-related quality of life (QOL) at week 28., Change in PR interval (sec) on ECG from baseline to week 4 stratified by class of antiretrovirals

Source: https://euclinicaltrials.eu/ctis-public/view/2024-513168-24-00